EU clinical trial 2023-510362-26-00: Carvedilol vs. flecainida clinical trial in idiopathic ventricular arrhythmias.
Protocol code: CARFLECT IV
Sponsor: Fundacion Instituto De Investigacion Sanitaria De Santiago De Compostela (Patient organisation/association). Phase: Therapeutic use (Phase IV). Countries: Spain (ongoing, recruiting).
Therapeutic area(s): Diseases [C] - Cardiovascular Diseases [C14]
Gender: Female, Male. Age: 18-64 years, 65+ years. Enrolment: 32.
Status: Ongoing, recruiting. Start date (EU): 2024-06-11. Decision date: 2024-04-02. Results received: No. Last updated: 2024-12-18.

Condition(s): Idiopathic ventricular arrhythmias
Product: CARVEDILOL, CARVEDILOL, FLECAINIDE

Primary endpoint: Difference between both groups in the average value of the ratio formed by dividing the number of ventricular beats measured in the 24-h Holter-ECG performed before starting treatment divided by the number of ventricular beats measured in the 24-h Holter-ECG performed after after completing treatment.
Endpoint(s): Comparison of the absolute reduction in the number of ventricular beats measured on the 24-h Holter before starting each treatment vs. after reaching the target doses. Analysis will be performed by intention to treat., Comparison of the % reduction of ectopic ventricular beats over the total number of beats recorded before starting each treatment vs. ECG obtained immediately before stopping said drug, with the previously titrated dose., Comparison of the percentage of patients who achieve a reduction in the number of ventricular extrasystoles greater than 80% in absolute number between both groups., A subgroup study will be carried out for the primary variable depending on the origin of the ventricular arrhythmia., Improvement in quality of life with the SF36 questionnaire., Change in LVEF and GLS strain (global longitudinal strain) of the left ventricle between the baseline TTE and that performed at the end of treatment with each drug., Number of patients who present any adverse effect during follow-up with each drug., Number of patients with serious adverse effects with each drug. We will understand serious adverse effects as all those that require admission or cause the death of the patient., Descriptives of the pathology.

Source: https://euclinicaltrials.eu/ctis-public/view/2023-510362-26-00